EU clinical trial 2023-504281-34-00: An open-label, multi-center, dose-escalation Phase Ib study to determine the recommended phase 2 dose of APN401 in patients with advanced solid tumors
Protocol code: APN401-104
Sponsor: Invios GmbH (Industry). Phase: Human Pharmacology (Phase I)- Other. Countries: Austria (ended).
Therapeutic area(s): Not possible to specify
Gender: Female, Male. Age: 18-64 years, 65+ years. Enrolment: 12.
Status: Ended. Start date (EU): 2023-08-22. End date (EU): 2024-11-20. Decision date: 2023-07-24. Results received: No. Last updated: 2024-04-08.

Condition(s): Adult patients with advanced solid tumors

Source: https://euclinicaltrials.eu/ctis-public/view/2023-504281-34-00